EU clinical trial 2026-525230-27-00: Bioequivalence clinical trial of two formulations of rosuvastatin.
Protocol code: UECHUP-ALT-RSV/26-1
Sponsor: Laboratorios Alter S.A. (Pharmaceutical company). Phase: Human Pharmacology (Phase I)- Bioequivalence Study. Countries: Spain (ended).
Therapeutic area(s): Diseases [C] - Cardiovascular Diseases [C14]
Gender: Female, Male. Age: 18-64 years. Enrolment: 36.
Status: Ended. Start date (EU): 2026-02-23. End date (EU): 2026-04-06. Decision date: 2026-02-17. Results received: No. Last updated: 2026-03-05.

Condition(s): Hypercholesterolemia

Source: https://euclinicaltrials.eu/ctis-public/view/2026-525230-27-00